EU clinical trial 2023-506844-18-00: Bioequivalence of Apixaban 5 mg Film-Coated Tablets: A Single-Dose, Open-Label, Randomized, Two-Sequence, Two-Treatment, Two-Period Crossover Study in Healthy Subjects Under Fasting Conditions.
Protocol code: CFA-1028-2-23
Sponsor: Laboratorios Cinfa S.A. (Pharmaceutical company). Phase: Human Pharmacology (Phase I)- Bioequivalence Study. Countries: Portugal (ended).
Therapeutic area(s): Not possible to specify
Gender: Female, Male. Age: 18-64 years. Enrolment: 24.
Status: Ended. Start date (EU): 2024-01-10. End date (EU): 2024-02-01. Decision date: 2023-12-11. Results received: Yes. Last updated: 2023-12-11.

Condition(s): No medical condition.
Product: Apixaban 5 mg film-coated tablets, Eliquis 5 mg film-coated tablets

Primary endpoint: Cmax and AUC0-t of apixaban will be the primary pharmacokinetic parameters.
Endpoint(s): Apixaban pharmacokinetic parameters: tmax, AUC0-∞, %AUCextrap, λz, and t½., Occurrence of treatment emergent adverse events (TEAEs), including clinically relevant abnormalities on vital signs or clinical laboratory tests.

Source: https://euclinicaltrials.eu/ctis-public/view/2023-506844-18-00